EU clinical trial 2023-508062-15-00: Evaluation of the efficacy and safety of stiripentol in patients 6 years and older with primary hyperoxaluria type 1, 2 or 3
Protocol code: STP226
Sponsor: Biocodex (Pharmaceutical company). Phase: Therapeutic confirmatory (Phase III). Countries: France (authorised, recruiting), Belgium (authorised, recruitment pending), Italy (authorised, recruitment pending).
Therapeutic area(s): Diseases [C] - Nutritional and Metabolic Diseases [C18]
Gender: Female, Male. Age: 0-17 years, 18-64 years, 65+ years. Enrolment: 19.
Start date (EU): 2026-07-15. Decision date: 2024-05-16. Results received: No. Last updated: 2026-05-18.
Decision dates by country: FR: 2024-05-21, BE: 2024-05-16, IT: 2024-05-20

Condition(s): Primary Hyperoxaluria (PH) of all subtypes (PH1, PH2 and PH3)
Product: Diacomit 250 mg hard capsules, Matched Placebo will consist in caspules similar to the 250 and 500 mg capsules of stiripentol but with no active ingredient, Diacomit 500 mg hard capsules

Primary endpoint: Percent change in 24-hour urinary oxalate excretion corrected for body surface area (BSA) from baseline to Month 6
Endpoint(s): Percent change in 24-hour urinary oxalate excretion corrected for body surface area (BSA) from baseline to Month 3, Absolute change in 24-hour urinary oxalate excretion corrected for body surface area (BSA) from baseline to Month 3 and Month 6, Change in 24-hour urine oxalate/creatinine ratio from baseline to Month 3 and Month 6, Proportion of patients with near normalisation of 24-hour urinary oxalate level corrected for BSA (defined as urinary oxalate lower than 1.5 x upper limit of normal (ULN)) at Month 3 and Month 6, Proportion of patients with normalisation of 24-hour urinary oxalate level corrected for BSA at Month 3 and Month 6, Change in estimated glomerular filtration rate (eGFR) from baseline to Month 6, Occurrence and frequency of kidney stone events during the follow-up, Change in urine oxalate/creatinine ratios as assessed in spot urine collections between baseline and Month 6, Change in biological parameters related to kidney stone formation between baseline and Month 6, Absolute change in the Pediatric Quality of Life Inventory (PedsQL [the generic and kidney failure (KF) modules]) for patients < 18 years of age (at screening) or in the Kidney Disease Quality of Life Questionnaire (KDQOL) for patients ≥ 18 years of age (at screening), Change in Euro Quality of Life Health State Profile Questionnaire (EQ-5D) and EQ-5D Visual Analog Scale (VAS)

Source: https://euclinicaltrials.eu/ctis-public/view/2023-508062-15-00